EU clinical trial 2024-518194-34-00: An open, single arm, single-center, Phase 1 trial investigating the effect of 7-days-repeated administration of linaprazan glurate on the pharmacokinetics of repeated doses of an approved antibiotic in healthy participants
Protocol code: CX842B2111
Sponsor: Cinclus Pharma Holding AB (publ) (Pharmaceutical company). Phase: Human Pharmacology (Phase I)- Other. Countries: Sweden (ended).
Therapeutic area(s): Diseases [C] - Digestive System Diseases [C06]
Gender: Female, Male. Age: 18-64 years. Enrolment: 12.
Status: Ended. Start date (EU): 2025-11-11. End date (EU): 2025-12-22. Decision date: 2025-01-21. Results received: No. Last updated: 2025-11-11.

Condition(s): Helicobacter pylori infection, GERD

Source: https://euclinicaltrials.eu/ctis-public/view/2024-518194-34-00